EU clinical trial 2023-509686-21-00: Phase 1 Study of PYX-106 in Solid Tumors
Protocol code: PYX-106-101
Sponsor: Pyxis Oncology Inc. (Pharmaceutical company). Phase: Human Pharmacology (Phase I)- First administration to humans. Countries: Spain (ended), Belgium (ended).
Therapeutic area(s): Diseases [C] - Neoplasms [C04]
Gender: Female, Male. Age: 18-64 years, 65+ years. Enrolment: 27.
Status: Ended. Start date (EU): 2023-07-05. End date (EU): 2025-05-26. End date: 2026-02-23. Decision date: 2024-01-11. Results received: No. Last updated: 2024-09-04.
Decision dates by country: BE: 2024-01-15, ES: 2024-01-11

Condition(s): Solid Tumors

Source: https://euclinicaltrials.eu/ctis-public/view/2023-509686-21-00